EU clinical trial 2025-523443-35-00: Phase 3, Multicenter, Randomized, Double-Masked, Vehicle-Controlled, Parallel Group Study to Evaluate the Safety and Efficacy of Recombinant Human Nerve Growth Factor Eye Drop Solution in Participants With Persistent Corneal Epithelial Defect (PCED)
Protocol code: NGF-PCED-301
Sponsor: Dompe' Farmaceutici S.p.A. (Pharmaceutical company). Phase: Therapeutic confirmatory (Phase III). Countries: Czechia (authorised, recruitment pending), Italy (authorised, recruitment pending), Netherlands (authorised, recruitment pending), Poland (ongoing, recruiting), Germany (authorised, recruitment pending), Spain (ongoing, recruiting), Hungary (authorised, recruitment pending), France (authorised, recruitment pending).
Therapeutic area(s): Diseases [C] - Eye Diseases [C11]
Gender: Female, Male. Age: 18-64 years, 65+ years. Enrolment: 91.
Start date (EU): 2026-06-11. Decision date: 2026-05-05. Results received: No. Last updated: 2026-08-07.
Decision dates by country: FR: 2026-05-11, HU: 2026-05-11, IT: 2026-05-08, ES: 2026-05-07, PL: 2026-05-08, NL: 2026-05-05, DE: 2026-05-06, CZ: 2026-05-05

Condition(s): Persistent Corneal Epithelial Defect (PCED)
Product: OXERVATE 20 micrograms/ml eye drops, solution, Vehicle for cenegermin drug product, TROPICAMIDE, COLIROFTA ANESTÉSICO DOBLE 1 MG/ML + 4 MG/ML COLIRIO EN SOLUCIÓN

Primary endpoint: Achieving complete epithelial healing at week 4 and maintained at week 8.
Endpoint(s): Percentage change from baseline in maximum diameter of PCED at week 4, Percentage change from baseline in maximum diameter of PCED at week 8, Achieving complete epithelial healing at week 8 and maintained at week 10, Linear change from baseline in maximum diameter (in mm) of the PCED at week 4

Source: https://euclinicaltrials.eu/ctis-public/view/2025-523443-35-00